EU clinical trial 2024-511855-16-00: A multi-center phase III randomized study comparing continuous versus fixed duration therapy with Daratumumab, Lenalidomide, and Dexamethasone for relapsed multiple myeloma (CONFIRM)
Sponsor: Assistance Publique Hopitaux De Paris (Hospital/Clinic/Other health care facility). Phase: Therapeutic confirmatory (Phase III). Countries: France (authorised, recruiting).
Therapeutic area(s): Diseases [C] - Neoplasms [C04]
Gender: Female, Male. Age: 18-64 years, 65+ years. Enrolment: 477.
Status: Authorised, recruiting. Start date (EU): 2019-07-25. Decision date: 2024-11-29. Results received: No. Last updated: 2026-08-06.

Condition(s): Onco-hematology
Product: LENALIDOMIDE, DEXAMETHASONE, DARZALEX 1800 mg solution for injection, DARATUMUMAB

Primary endpoint: Overall survival (OS) at 4 years after randomization and initiation of salvage therapy.
Endpoint(s): Response rate according to the IMWG criteria (Durie BG, et al. Leukemia. 2006;20 :1467–1473; Rajkumar SV, et al. Blood. 2011;4691-4695), during or after the study treatment at the time of data cutoff., Overall response rate, defined as the proportion of subjects who achieve CR or PR according to the IMWG criteria, following salvage therapy., PFS which is defined as the duration from the date of randomization to either progressive disease, according to the IMWG criteria or death, at 4 years after randomization., Incidence of adverse events within the 4 years after randomization, QoL will be evaluated after randomization every 12 weeks until disease progression and then at last follow-up based on the EORTC QLQ-C30 (European Organisation for Research and Treatment of Cancer Quality of Life Questionnaire-Core 30) and the EQ-5D 5L (EuroQol - five dimension - five levels)., The Incremental cost-effectiveness ratios (ICERs) expressed in cost per quality adjusted life year (QALY) gained, in cost per Life Year Gained, and in cost per progression free year gained., The budget impact analysis based upon target and prevalent populations’ estimations

Source: https://euclinicaltrials.eu/ctis-public/view/2024-511855-16-00